EU clinical trial 2024-512602-26-00: Ulipristal versus standard surgical treatment in symptomatic uterine fibroids
Protocol code: NL62638.029.18
Sponsor: Amsterdam UMC Stichting (Hospital/Clinic/Other health care facility). Phase: Therapeutic use (Phase IV). Countries: Netherlands (ongoing, recruiting).
Therapeutic area(s): Diseases [C] - Female Urogenital Diseases and Pregnancy Complications [C13]
Gender: Female. Age: 18-64 years. Enrolment: 164.
Status: Ongoing, recruiting. Start date (EU): 2024-12-02. Decision date: 2024-12-02. Results received: No. Last updated: 2024-12-02.

Condition(s): Uterine fibroids
Product: Esmya 5 mg tablets

Primary endpoint: Primary study parameter with regard to the patient is the uterine fibroid symptom quality of life questionnaire (UFS-QOL), generating a symptom severity score (SSS) at 24 months after randomization., The other primary outcome relates to costs, with a breakdown to: Direct health care costs; Costs due to loss of productivity (absenteeism from work); Patient costs (informal care, other care services paid for by patients themselves)
Endpoint(s): What is the effect of the intervention on quality of life parameters, such as pain, societal participation and sexual functioning?, What is the effect of the intervention on fibroid specific complaints such as volume reduction (UPA group); amount of menstrual bleeding (PBAC-score) and Hemoglobin level., What is the re-intervention rate in both treatment groups and how many patients choose for an intervention after treatment with UPA?, What is the effect on patient preference and satisfaction?, Which complications/side-effects occur?, What is the effect of UPA-usage on the blood results, regarding liver function?, Which sub-groups benefit most within the study group (subgroup-analysis)

Source: https://euclinicaltrials.eu/ctis-public/view/2024-512602-26-00